EU clinical trial 2022-502988-37-00: A Phase III, Randomized, Double-Blind, Placebo-Controlled Study of Atezolizumab Plus Carboplatin and Etoposide with or Without Tiragolumab (Anti-Tigit Antibody) in Patients with Untreated Extensive-Stage Small Cell Lung Cancer
Protocol code: GO41767
Sponsor: F. Hoffmann-La Roche AG (Pharmaceutical company). Phase: Therapeutic confirmatory (Phase III). Countries: Greece (ended), Italy (ended), Poland (ended).
Therapeutic area(s): Diseases [C] - Neoplasms [C04]
Gender: Female, Male. Age: 18-64 years, 65+ years. Enrolment: 90.
Status: Ended. Start date (EU): 2020-06-19. End date (EU): 2025-07-31. End date: 2025-08-01. Decision date: 2024-09-23. Results received: Yes. Last updated: 2025-04-10.
Decision dates by country: IT: 2024-09-23, PL: 2024-10-21, GR: 2024-09-23

Condition(s): Small cell lung cancer (SCLC)
Product: Placebo tiragolumab, Tecentriq 1 200 mg concentrate for solution for infusion, Tiragolumab

Primary endpoint: 1. Progression-free survival in the PAS, 2. Overall survival in the PAS
Endpoint(s): 1. Progression free survival in the FAS, 2. Overall survival in the FAS, 3. Confirmed objective response rate in the PAS and FAS population, 4. Duration of response in the PAS and FAS population, 5. Progression-free survival rates at 6 months and at 12 months in the PAS and FAS population, 6. Overall survival rates at 12 months and 24 months in the PAS and FAS population, 7. Time to confirmed deterioration in the PAS and FAS population, 8. Incidence and severity of adverse events, with severity determined according to National Cancer Institute Common Terminology Criteria for Adverse Events, Version 5.0, 9. Severity for cytokine-release syndrome (CRS) will also be determined according to the American Society for Transplantation and Cellular Therapy (ASTCT) CRS consensus grading scale, 10. Minimum serum concentration [Cmin]of tiragolumab and atezolizumab at specified timepoints, 11. Maximum serum concentration [Cmax] of tiragolumab and atezolizumab at specified timepoints, 12. Prevalence of ADAs to tiragolumab and atezolizumab at baseline and during the study, 13. Change in EuroQol 5-Dimension, 5-Level Questionnaire (EQ-5D-5L) index-based and Visual Analog Scale scores at specified timepoints during the study

Source: https://euclinicaltrials.eu/ctis-public/view/2022-502988-37-00